EU clinical trial 2023-504653-12-00: A PROSPECTIVE, OPEN-LABEL, MULTICENTRE PHASE-II-TRIAL TO EVALUATE THE EFFICACY AND SAFETY OF ZANUBRUTINIB (BGB-3111), A BTK INHIBI-TOR, PLUS TISLELIZUMAB (BGB-A317), A PD-1 INHIBITOR, WITH AND WITH-OUT SONROTOCLAX (BGB-11417), A BCL2 INHIBITOR, FOR TREATMENT OF PATIENTS WITH RICHTER TRANSFORMATION - CLL-RT1-Trial
Protocol code: CLL-RT1
Sponsor: University Of Cologne (Educational Institution). Phase: Therapeutic exploratory (Phase II). Countries: Denmark (ongoing, recruiting), Germany (ongoing, recruiting), Austria (ongoing, recruiting).
Therapeutic area(s): Diseases [C] - Neoplasms [C04]
Gender: Female, Male. Age: 18-64 years, 65+ years. Enrolment: 107.
Status: Ongoing, recruiting. Start date (EU): 2020-02-10. Decision date: 2023-10-24. Results received: No. Last updated: 2026-05-27.
Decision dates by country: DE: 2023-11-01, AT: 2023-11-22, DK: 2023-10-24

Condition(s): Patients with previously untreated Richter Transformation or patients who responded to up to one prior line of RT therapy
Product: BGB-11417, BGB-11417, Zanubrutinib, Tislelizumab, BGB-11417, BGB-11417

Primary endpoint: Overall response rate (ORR) after induction therapy (i.e. 6 cycles) according to the refined Lugano Classification (Cheson et al, 2016). - Complete response (CR) - Partial response (PR)

Source: https://euclinicaltrials.eu/ctis-public/view/2023-504653-12-00